EU clinical trial 2024-517171-20-00: A Prospective Multicenter Randomized Controlled, Open-label Study to Compare the Efficacy of Subcutaneous Infliximab Monotherapy with Subcutaneous Infliximab and Concomitant Immunosuppression in the Treatment of Moderate to Severe Crohn’s Disease ( Direct-CD)
Protocol code: NL76663.018.21
Sponsor: Amsterdam UMC Stichting (Hospital/Clinic/Other health care facility). Phase: Therapeutic use (Phase IV). Countries: Netherlands (ended).
Therapeutic area(s): Diseases [C] - Digestive System Diseases [C06]
Gender: Female, Male. Age: 18-64 years, 65+ years. Enrolment: 158.
Status: Ended. End date (EU): 2025-11-20. Decision date: 2024-09-05. Results received: No. Last updated: 2024-09-05.

Condition(s): Crohn's disease
Product: Remsima 120 mg solution for injection in pre-filled pen

Primary endpoint: The proportion of patients in corticosteroid-free clinical remission (as defined by CDAI<150) AND endoscopic response (a drop of at least 50% in SES-CD compared to baseline) at week 26
Endpoint(s): The proportion of patients in endoscopic remission at week 26 (defined as the absence of ulcerations larger then 5mm) • Proportion of patients with endoscopic remission at week 26 (as measured by SES-CD≤2) • Proportion of patients with endoscopic response at week 26 (as measured by at least 50% reduction in the SES-CD as compared to baseline) • Proportion of patients in corticosteroid-free clinical remission at week 26 (defined as a CDAI<150)

Source: https://euclinicaltrials.eu/ctis-public/view/2024-517171-20-00